EU clinical trial 2024-519745-30-01: A Phase 1b/2a, Open-Label, Sequential-Cohort, Dose Escalation and Expansion Study to Evaluate Safety, Tolerability, Pharmacokinetics, Pharmacodynamics, and Preliminary Clinical Effectiveness of Budoprutug (TNT119) in Subjects with Immune Thrombocytopenia (ITP)
Protocol code: TNT119-ITP-201
Sponsor: Climb Bio Inc. (Pharmaceutical company). Phase: Phase I and Phase II (Integrated)- Other. Countries: Greece (ongoing, recruiting), Spain (ongoing, recruiting), Bulgaria (ongoing, recruiting).
Therapeutic area(s): Diseases [C] - Hemic and Lymphatic Diseases [C15]; Diseases [C] - Immune System Diseases [C20]
Gender: Female, Male. Age: 18-64 years, 65+ years. Enrolment: 13.
Status: Ongoing, recruiting. Start date (EU): 2025-12-19. Decision date: 2025-11-03. Results received: No. Last updated: 2026-08-05.
Decision dates by country: BG: 2025-11-03, ES: 2025-11-04, GR: 2025-11-04

Condition(s): Immune Thrombocytopenia (ITP)
Product: Budoprutug

Primary endpoint: 1. Incidence, relatedness, severity, and duration of treatment-emergent adverse events (TEAEs) and dose-limiting toxicities (DLTs).
Endpoint(s): 1. Budoprutug PK parameters (including area under the concentration-time curve, maximum observed concentration, time to maximum observed concentration, terminal half-life, apparent clearance, and volume of distribution)., 2. The change from baseline in absolute peripheral cluster of differentiation (CD)20+ B-cell count., 3. The change in platelet count observed with budoprutug over time in subjects with ITP., 4. The percentage of subjects with ITP who achieve a stable, partial, and complete response by Week 12. Note: A stable, partial, and complete response is defined as a platelet count ≥ 30,000/μL, ≥ 50,000/μL, or ≥ 100,000/μL, respectively, on at least 2 occasions at least 7 days apart within a 30-day time frame., 5. The change in serum IgG, IgM, and IgA from baseline over time., 6. The incidence of subjects who develop ADAs at any time after study drug administration., 7. The percentage of subjects on a steroid at baseline who are able to stop steroid treatment.

Source: https://euclinicaltrials.eu/ctis-public/view/2024-519745-30-01